EU clinical trial 2023-505711-20-00: Treatment of non-type 2 CRSwNP with anti-IL-17 antibody (secukinumab)
Protocol code: 1
Sponsor: Tartu University Hospital (Hospital/Clinic/Other health care facility). Phase: Therapeutic use (Phase IV). Countries: Estonia (ended).
Therapeutic area(s): Diseases [C] - Otorhinolaryngologic Diseases [C09]
Gender: Female, Male. Age: 18-64 years. Enrolment: 4.
Status: Ended. Start date (EU): 2023-08-13. End date (EU): 2024-01-23. Decision date: 2023-08-11. Results received: Yes. Last updated: 2023-08-11.

Condition(s): Chronic rhinosinusitis with nasal polyps
Product: Cosentyx 150 mg solution for injection in pre-filled syringe

Primary endpoint: mean change of NPS and SNOT-22 scores from baseline to week 16
Endpoint(s): mean change from baseline to week 16 in IL-17 associated inflammatory markers

Source: https://euclinicaltrials.eu/ctis-public/view/2023-505711-20-00